EU clinical trial 2022-502616-37-00: An Open-Label, Phase I/II Study to Evaluate the Safety, Pharmacokinetics and Preliminary Anti-Tumor Activity of Englumafusp Alfa (RO7227166, a CD19 Targeted 4-1BB Ligand) in Combination with Obinutuzumab and in Combination with Glofitamab Following a Pre-Treatment Dose of Obinutuzumab Administered in Participants with Relapsed/Refractory B-Cell Non-Hodgkin’s Lymphoma
Protocol code: BP41072
Sponsor: F. Hoffmann-La Roche AG (Pharmaceutical company). Phase: Phase I and Phase II (Integrated)- Other. Countries: Spain (ongoing, recruitment ended), Denmark (ongoing, recruitment ended), Belgium (ongoing, recruitment ended), Italy (ongoing, recruitment ended), France (ongoing, recruitment ended).
Therapeutic area(s): Diseases [C] - Neoplasms [C04]
Gender: Female, Male. Age: 18-64 years, 65+ years. Enrolment: 194.
Status: Ongoing, recruitment ended. Start date (EU): 2019-07-30. Decision date: 2024-02-27. Results received: No. Last updated: 2026-03-31.
Decision dates by country: FR: 2024-03-22, BE: 2024-02-28, DK: 2024-02-27, ES: 2024-02-27, IT: 2024-03-26

Condition(s): Relapsed/Refractory B-Cell Non-Hodgkin’s Lymphoma (r/r B-cell NHL)
Product: RoActemra 20 mg/mL concentrate for solution for infusion, CD19 4-1 BBL, Gazyvaro 1,000 mg concentrate for solution for infusion., Columvi 10 mg concentrate for solution for infusion

Primary endpoint: Part I/II 1. Nature and frequency of dose-limiting toxicities (DLTs), Part I/II 2. Incidence, nature, and severity of adverse events (AEs) graded according to the National Cancer Institute Common Terminology Criteria for Adverse Events (NCI CTCAE) v5.0 and for CRS the American Society for Transplantation and Cellular Therapy (ASTCT) consensus grading, Part III 3. Investigator assessed CR rate as assessed by FDG-PET/CT scan
Endpoint(s): Part I/II 1. Total exposure (area under the concentration time curve [AUC]) of englumafusp alfa in combination with obinutuzumab and glofitamab, Part I/II 2. Maximum serum concentration (peak concentration, Cmax) of englumafusp alfa in combination with obinutuzumab and glofitamab, Part I/II 3. Minimum serum concentration (trough concentration, Cmin) of englumafusp alfa in combination with obinutuzumab and glofitamab, Part I/II 4. Clearance (CL), Volume of distribution of steady state (Vss) and half-life (t½) if data permit, Part I/II 5. Analysis of dose-linearity in exposure, Part I/II 6. Additional PK parameters may be determined as appropriate, Part I/II 7. Incidence and titer of englumafusp alfa anti-drug antibodies (ADAs) during the study relative to prevalence of ADAs at baseline, Part I/II 8. Overall response rate (ORR), Part I/II 9. Disease control rate (DCR), Part III 10. Incidence, nature, and severity of AEs graded according to the NCI CTCAE v5.0 and for CRS the American Society for Transplantation and Cellular Therapy (ASTCT) consensus grading, Part III 11. Total exposure (area under the concentration time curve [AUC]) of englumafusp alfa in combination with glofitamab, Part III 12. Maximum serum concentration (peak concentration, Cmax) of englumafusp alfa in combination with glofitamab, Part III 13. Minimum serum concentration (trough concentration, Cmin) of englumafusp alfa in combination with glofitamab, Part III 14. Clearance (CL), Volume of distribution of steady state (Vss) and half-life (t½) if data permit of englumafusp alfa in combination with glofitamab, Part III 15. Analysis of dose-linearity in exposure, Part III 16. Additional PK parameters may be determined as appropriate, Part III 17. Incidence and titer of englumafusp alfa anti-drug antibodies (ADAs) during the study relative to prevalence of ADAs at baseline, Part III 18. Overall response rate (ORR), Part III 19. Duration of complete response (DOCR), Part III 20. Progression-free survival (PFS), Part III 21. Overall survival (OS), Part III 22.Time to first complete response (TFCR), Part III 23. Time to first overall response (TFOR), Part III 24 Change from baseline in physical function, role function, and HRQoL based on EORTC QLQ C30, Part III 25. Change from baseline in disease-related symptoms based on the FACT-Lym Lymphoma scale, Part III 26. Baseline levels and change from baseline of cellular biomarkers in blood and tumor tissue, using markers of B, and T-cell lineage, Part I/II 27. Baseline levels and change from baseline of cellular biomarkers in blood, using markers of B-, T- and NK-cell lineage

Source: https://euclinicaltrials.eu/ctis-public/view/2022-502616-37-00